EU clinical trial 2023-508499-12-00: A Randomized, Double-blind, Placebo-controlled Multicenter Phase 3 Study to Evaluate Efficacy, Safety and Tolerability of Ianalumab on Top of Standard-of-care Therapy in Patients With Systemic Lupus Erythematosus (SIRIUS-SLE 2)
Protocol code: CVAY736F12302
Sponsor: Novartis Pharma AG (Pharmaceutical company). Phase: Therapeutic confirmatory (Phase III). Countries: Germany (ongoing, recruitment ended), Romania (ongoing, recruitment ended), France (ongoing, recruitment ended), Italy (ongoing, recruitment ended).
Therapeutic area(s): Diseases [C] - Immune System Diseases [C20]
Gender: Female, Male. Age: 0-17 years, 18-64 years, 65+ years. Enrolment: 67.
Status: Ongoing, recruitment ended. Start date (EU): 2023-05-17. Decision date: 2024-06-18. Results received: No. Last updated: 2026-05-05.
Decision dates by country: DE: 2024-06-18, RO: 2024-06-21, FR: 2024-06-28, IT: 2024-06-24

Condition(s): Systemic Lupus Erythematosus
Product: VAY736, ENTECAVIR, Placebo to VAY736, TENOFOVIR DISOPROXIL, TENOFOVIR ALAFENAMIDE

Primary endpoint: Proportion of participants achieving SRI-4 at Week 60
Endpoint(s): Proportion of participants with no moderate or severe British Isles Lupus Assessment Group flare up to Week 60, Proportion of participants maintaining between Week 36 and Week 60 a reduced corticosteroid dose of predniso(lo)ne ≤5 mg/day or ≤baseline dose, whichever is lower, Proportion of participants achieving British Isles Lupus Assessment Group-based Composite Lupus Assessment at Week 60, Proportion of participants achieving Lupus Low Disease Activity State at Week 60, Time to first occurrence of SRI-4 from baseline to Week 60, Proportion of participants achieving SRI-4 at Week 60 while maintaining between Week 36 and Week 60 a reduced corticosteroid dose of predniso(lo)ne ≤5 mg/day or ≤baseline dose, whichever is lower, Proportion of participants achieving SRI-6 at Week 60, Proportion of participants achieving SF-36 Bodily Pain response at Week 60, Proportion of participants with AEs and SAEs, Clinical laboratory measurements, Vital Signs, Incidence and titer of anti-ianalumab antibodies in serum (ADA assay) over time, Ianalumab concentration in serum during the treatment and followup (up to the end of study)

Source: https://euclinicaltrials.eu/ctis-public/view/2023-508499-12-00